EU clinical trial 2024-520345-23-00: EFFICACY AND SAFETY OF LOCAL TREATMENT OF TRAPEZIUS MYOFASCIAL SYNDROME IN PATIENTS WITH FIBROMYALGIA THROUGH ULTRASOUND-GUIDED INTERFASCIAL BLOCK OF THE TRAPEZIUS MUSCLE
Protocol code: TRAPEZIUS
Sponsor: Fundacio De Recerca Clinic Barcelona-Institut D’Investigacions Biomediques August Pi I Sunyer (Laboratory/Research/Testing facility). Phase: Therapeutic use (Phase IV). Countries: Spain (authorised, recruitment pending).
Therapeutic area(s): Analytical, Diagnostic and Therapeutic Techniques and Equipment [E] - Anesthesia and Analgesia [E03]
Gender: Female, Male. Age: 18-64 years. Enrolment: 69.
Status: Authorised, recruitment pending. Decision date: 2025-01-15. Results received: No. Last updated: 2025-01-15.

Condition(s): TRAPEZIUS MYOFASCIAL SYNDROME IN FIBROMYALGIA PATIENTS
Product: KENACORT 40 mg/ml sospensione iniettabile, Suero Fisiológico Braun 0,9% disolvente para uso parenteral Cloruro de sodio, Lidocaína B. Braun 20 mg/ml solución inyectable, BUPIVACAÍNA PHYSAN 0,25% SOLUCIÓN INYECTABLE

Primary endpoint: Visual Analogue Scale (VAS) of regional trapezius pain selected for treatment, at weeks 2, 4 and 12.
Endpoint(s): Visual Analogue Scale (VAS) of the patient's general pain, Visual Analog Scale (VAS) of patient fatigue, Sensitivity points measured by algometer with a force of 4 kg, WPI and SSS, Sleep assessment: Pittsburg Index (PSQI)., Functional Capacity (FIQ)., Quality of Life (SF-36), Level of anxiety / depression (HAD).

Source: https://euclinicaltrials.eu/ctis-public/view/2024-520345-23-00